EU clinical trial 2024-516544-26-00: Local tenecteplase applicatiOn subsequent to endovasCular recanalization in Anterior circuLation stroke - the LOCAL trial
Protocol code: LOCAL
Sponsor: Universitaetsklinikum Heidelberg AöR (Hospital/Clinic/Other health care facility). Phase: Therapeutic exploratory (Phase II). Countries: Germany (ongoing, recruiting).
Therapeutic area(s): Diseases [C] - Cardiovascular Diseases [C14]
Gender: Female, Male. Age: 18-64 years, 65+ years. Enrolment: 380.
Status: Ongoing, recruiting. Start date (EU): 2026-03-30. Decision date: 2025-10-23. Results received: No. Last updated: 2026-04-28.

Condition(s): acute ischemic stroke
Product: Metalyse 5 000 units (25 mg) powder for solution for injection, Tenecteplase Placebo

Primary endpoint: To investigate whether supplementary intra-arterial administration of thrombolysis (Tenecteplase) after successful endovascular recanalization of anterior circulation ischemic stroke results in improved clinical outcome evaluated based on the proportion of patients with an excellent clinical outcome of mRS 0 – 1 after 90 days +/- 15 days

Source: https://euclinicaltrials.eu/ctis-public/view/2024-516544-26-00